EU clinical trial 2023-510521-14-00: A Phase 1b study of inhaled RCT1100 in Adults with Primary Ciliary Dyskinesia Caused by Pathogenic Mutations in the DNAI1 Gene to Measure Mucociliary Clearance
Protocol code: RCT1100-103
Sponsor: Recode Therapeutics Inc. (Pharmaceutical company). Phase: Human Pharmacology (Phase I)- Other. Countries: Denmark (ended), Germany (ended).
Therapeutic area(s): Diseases [C] - Respiratory Tract Diseases [C08]
Gender: Female, Male. Age: 18-64 years, 65+ years. Enrolment: 12.
Status: Ended. Start date (EU): 2024-10-18. End date (EU): 2025-09-19. End date: 2026-01-08. Decision date: 2024-05-28. Results received: No. Last updated: 2025-10-07.
Decision dates by country: DK: 2024-05-28, DE: 2024-05-30

Condition(s): Adults with Primary Ciliary Dyskinesia

Source: https://euclinicaltrials.eu/ctis-public/view/2023-510521-14-00